EU clinical trial 2024-511667-28-00: A study to investigate the safety and efficacy of SAR446523 injected subcutaneously in adult participants with relapsed/refractory myeloma
Protocol code: TED18162
Sponsor: Sanofi-Aventis Recherche & Developpement (Pharmaceutical company). Phase: Human Pharmacology (Phase I)- First administration to humans. Countries: Spain (ongoing, recruiting), Italy (ongoing, recruiting), France (ongoing, recruiting).
Therapeutic area(s): Diseases [C] - Neoplasms [C04]
Gender: Female, Male. Age: 18-64 years, 65+ years. Enrolment: 30.
Status: Ongoing, recruiting. Start date (EU): 2025-07-21. Decision date: 2024-12-09. Results received: No. Last updated: 2026-06-18.
Decision dates by country: ES: 2024-12-09, IT: 2024-12-10, FR: 2025-09-24

Condition(s): Plasma cell myeloma refractory

Source: https://euclinicaltrials.eu/ctis-public/view/2024-511667-28-00